EU clinical trial 2023-507632-20-00: A Phase 3 Randomized Study Comparing Daratumumab, Bortezomib, Lenalidomide and Dexamethasone (DVRd) followed by Ciltacabtagene Autoleucel versus Daratumumab, Bortezomib, Lenalidomide and Dexamethasone (DVRd) followed by Autologous Stem Cell Transplant (ASCT) in Participants with Newly Diagnosed Multiple Myeloma who are Transplant Eligible
Protocol code: EMN2868284528MMY3005
Sponsor: European Myeloma Network B.V., Emn Trial Office S.r.l. Impresa Sociale (Patient organisation/association, Laboratory/Research/Testing facility). Phase: Therapeutic confirmatory (Phase III). Countries: Spain (ongoing, recruiting), France (ongoing, recruiting), Netherlands (ongoing, recruiting), Czechia (ongoing, recruiting), Sweden (ongoing, recruiting), Germany (ongoing, recruiting), Belgium (ongoing, recruiting), Norway (ongoing, recruiting), Greece (ongoing, recruiting).
Therapeutic area(s): Diseases [C] - Neoplasms [C04]
Gender: Female, Male. Age: 18-64 years, 65+ years. Enrolment: 440.
Status: Ongoing, recruiting. Start date (EU): 2024-05-01. Decision date: 2024-05-01. Results received: No. Last updated: 2026-06-17.
Decision dates by country: CZ: 2024-05-03, NO: 2024-05-02, BE: 2024-05-08, NL: 2024-05-01, FR: 2024-05-06, DE: 2024-05-22, SE: 2024-05-06, GR: 2024-06-28, ES: 2024-05-03

Condition(s): Multiple Myeloma
Product: Dexamethason Teva 4 mg, tabletten, Dexamethasone 2mg Tablets , Lenalidomide Accord 2.5 mg hard capsules, Lenalidomide Accord 20 mg hard capsules, VELCADE 3.5 mg powder for solution for injection, DARZALEX 1800 mg solution for injection, Lenalidomide Accord 5 mg hard capsules, CARVYKTI 3.2 × 10^6 – 1.0 × 10^8 cells dispersion for infusion, Lenalidomide Accord 15 mg hard capsules, Lenalidomide Accord 25 mg hard capsules

Primary endpoint: PFS, Sustained MRD-negative CR, defined as MRD-negative CR for at a minimum 12 months duration, with MRD status determined by NGS with a sensitivity of at least 10-5
Endpoint(s): Overall response (PR or better) status and CR or better status, Overall MRD-negative CR with a sensitivity of at least 10-5, Time to subsequent antimyeloma therapy, PFS on next-line therapy (PFS2), Incidence, severity, and type of AEs, clinical laboratory results, and other safety parameters, OS, PK and pharmacodynamic markers by protein, DNA, or RNA analyses, including but not limited to, systemic inflammatory cytokine concentrations, markers of CAR-T cell expansion (proliferation) and persistence via monitoring of cilta-cel-positive cellular concentrations, and cilta-cel transgene levels, Mean change from baseline in the EORTC-QLQ-C30, MySIm-Q, and EQ-5D-5L subscale scores and the PROCTCAE items, Time to improvement or worsening of symptoms, functioning, and overall well-being, Improvement or worsening in the EORTC-QLQ- C30 and MySIm-Q subscale scores using the PGIS to calculate the meaningful change threshold, Presence of RCL

Source: https://euclinicaltrials.eu/ctis-public/view/2023-507632-20-00